EU clinical trial 2025-524576-28-00: Intrathecal Administration of MELPIDA For Hereditary Spastic Paraplegia Type 50 (SPG50): A multicenter Phase 3, Open-Label Trial with Matched Prospective Concurrent Control Arm (CT-MEL-03)
Protocol code: CT-MEL-03
Sponsor: Elpida Therapeutics SPC (Pharmaceutical company). Phase: Therapeutic confirmatory (Phase III). Countries: Spain (authorised, recruitment pending).
Therapeutic area(s): Diseases [C] - Congenital, Hereditary, and Neonatal Diseases and Abnormalities [C16]
Gender: Female, Male. Age: 0-17 years. Enrolment: 12.
Status: Authorised, recruitment pending. Decision date: 2026-07-17. Results received: No. Last updated: 2026-07-17.

Condition(s): Hereditary Spastic Paraplegia Type 50 (SPG50)
Product: PREDNISONE, Melpida, TACROLIMUS, DIPHENHYDRAMINE, METHYLPREDNISOLONE, PARACETAMOL, SIROLIMUS, GADOTERIC ACID

Primary endpoint: 8 motor milestone achievements taken from items of the Gross Motor Function Measure (GMFM-88) using a 2-point scale (achieves =1 / does not achieve =0) so the highest possible score for an individual is 8. Week 156 Change from baseline (CFB) in the trajectory of the 8 Major Milestones Total Score.
Endpoint(s): Composite Endpoint Defined by the Win Ratio using matching criteria after 156 Weeks of Follow-up of the 8 selected items and the raw scores of the Cognitive domain of the Bayley Scale of Infant and Toddler Development 3rd Edition (Bayley-3)., Week 156: Disease Severity (Spastic Paraplegia Rating Scale [SPRS]). Trajectory in CFB in spasticity and weakness Subscore (Items 7 to 10), Week 156: Disease Severity (Clinical Global Impression [CGI-I]) Trajectory in CFB in Physician-assessed CGI-I., Week 156: Trajectory in Change in total percent score of the GMFM-88 from baseline in treated group compared to change in total percent score of GMFM-88 total Scores from baseline in untreated controls., Week 156: Developmental Milestones- Bayley-3 Cognitive Domain- Trajectory in CFB in Raw Score., Week 156: 10-meter walk test (item 3 of SPRS); CFB in treated and untreated., Week 156: Differential Ability Scales, 2nd Edition (DAS-II). Trajectory in CFB in Total Score, Week 156: Disease Severity (Spastic Paraplegia Rating Scale [SPRS]). Trajectory in CFB in Total Score, Health Related Quality of Life (The Caregiver Priorities and Child Health Index of Life with Disabilities [CPCHILD]) Trajectory in CFB in Total Score, Developmental Milestones (Vineland Adaptive Behavior Scale 3rd Edition [Vineland-3]). Trajectory in CFB in Total Score., Developmental Milestones (Developmental Quotients [DQs]), Trajectory in CFB in DQs for Gross Motor, Adaptive behavior and Cognitive Scores., Axonal Damage (Plasma neurofilament light chain levels [NfL]). Trajectory in CFB in Plasma NfL levels., Disease Severity (Parent-rated Global Impression [PGI-I]) Trajectory in CFB in Global Impression as assessed by the primary caregiver., Serum and/or Plasma biomarkers. Trajectory in CFB in Biomarker Levels from Baseline.

Source: https://euclinicaltrials.eu/ctis-public/view/2025-524576-28-00